EU clinical trial 2024-519189-31-00: Adjuvant Pressurized IntraPeritoneal Aerosol Chemotherapy (PIPAC) in resected high risk colon cancer patients. - The PIPAC-OPC3 CC trial,
Protocol code: PIPACOPC3CC
Sponsor: Odense University Hospital (Hospital/Clinic/Other health care facility). Phase: Therapeutic exploratory (Phase II). Countries: Denmark (ongoing, recruitment ended).
Therapeutic area(s): Diseases [C] - Neoplasms [C04]
Gender: Female, Male. Age: 18-64 years, 65+ years. Enrolment: 60.
Status: Ongoing, recruitment ended. Start date (EU): 2024-12-04. Decision date: 2024-12-03. Results received: No. Last updated: 2024-12-03.

Condition(s): Colon cancer
Product: OXALIPLATIN

Primary endpoint: The proportion of patients with peritoneal recurrence on contrast enhanced CT of the thorax and abdomen 36 months after resection of high-risk colon cancer
Endpoint(s): Treatment related toxicity and complication rate, Completion rate of two adjuvant PIPAC treatments, 1- and 2-year peritoneal recurrence free survival, based on CT of the thorax and abdomen, 1-, 2- and 3-year recurrence free survival, based on CT of the thorax and abdomen, 1-, 3- and 5-year overall survival rate, The number of conversions from positive to negative peritoneal lavage cytology after one PIPAC procedure

Source: https://euclinicaltrials.eu/ctis-public/view/2024-519189-31-00